EU clinical trial 2022-501154-11-00: Efficacy and tolerability of horse chestnut seed extract on swelling in patients undergoing meniscus surgery: a placebo-controlled, randomized, double-blind, single-center, pilot study
Protocol code: CES AES 01/21
Sponsor: Cesra Arzneimittel GmbH & Co. KG (Pharmaceutical company). Phase: Therapeutic exploratory (Phase II). Countries: Germany (ended).
Therapeutic area(s): Diseases [C] - Musculoskeletal Diseases [C05]
Gender: Female, Male. Age: 18-64 years, 65+ years. Enrolment: 60.
Status: Ended. Start date (EU): 2023-05-31. End date (EU): 2024-05-06. Decision date: 2023-02-13. Results received: Yes. Last updated: 2023-09-06.

Condition(s): post-operative swelling, pain and edema
Product: Tablets identical to "Test" in appearance and taste but containing no active ingredient, Aescuven 12,5 mg überzogene Tablette

Primary endpoint: Volume of the affected knee at visit 5, as determined by optoelectronic measurements, Patient reported outcome measures at visit 5 (co-primary endpoint)
Endpoint(s): Volume of affected knee at visit 1, visit 2 (before surgery), visit 3 and visit 4, as determined by optoelectronic measurements, Circumference of affected knee as determined by optoelectronic measurements at visit 1, visit 2 (before surgery), visits 3, 4, and 5, Circumference of affected knee as determined by tape at visit 1, visit 2 (before surgery), visits 3, 4 and 5, Range of motion (ROM) of the affected knee joint (Goniometry) at visit 1, visit 2 (before surgery), visits 3, 4 and 5, Skin temperature at surgery site at visit 1, visit 2 (before surgery), visits 3, 4 and 5, Volume of drained fluid after knee surgery at visit 3, PROM at visits 1 - 4, EQ-5D-5L Quality of Life questionnaire [15] at visit 1 and 5, Efficacy of IMP as judged by the Investigator at final visit (end of study), Cumulative usage of analgetic drugs from visit 2 to final visit

Source: https://euclinicaltrials.eu/ctis-public/view/2022-501154-11-00